EU clinical trial 2025-523537-26-00: KontRASt-R: An open-label, multi-center, rollover study for participants who have been previously enrolled into a Novartis-sponsored opnurasib (JDQ443) study and are continuing to benefit from opnurasib as a single agent or in combination with other study treatments
Protocol code: CJDQ443B12105B
Sponsor: Novartis Pharma AG (Pharmaceutical company). Phase: Phase I and Phase II (Integrated)- Other. Countries: Spain (authorised, recruitment pending), Italy (ongoing, recruiting), France (ongoing, recruiting), Denmark (authorised, recruitment pending), Belgium (ongoing, recruiting).
Therapeutic area(s): Diseases [C] - Neoplasms [C04]
Gender: Female, Male. Age: 18-64 years, 65+ years. Enrolment: 31.
Start date (EU): 2026-07-07. Decision date: 2026-06-08. Results received: No. Last updated: 2026-06-11.
Decision dates by country: BE: 2026-06-08, DK: 2026-06-11, FR: 2026-06-08, IT: 2026-06-09, ES: 2026-06-11

Condition(s): Locally advanced or metastatic KRAS G12C-mutated non-small cell lung cancer; advanced solid tumors harboring the KRAS G12C mutation.
Product: TNO155, Erbitux 5 mg/mL solution for infusion, JDQ443, VDT482

Primary endpoint: Number of participants receiving opnurasib as single agent or in combination with other study treatments and duration of exposure
Endpoint(s): Safety and tolerability: • Frequency and severity/grade of adverse events (AEs) • Dose interruptions, reductions, and discontinuations

Source: https://euclinicaltrials.eu/ctis-public/view/2025-523537-26-00